EU clinical trial 2023-504903-10-00: Comparative Bioavailability of Midazolam 7.5 mg/1.5 mL Oromucosal Solution (Buccolam®) Versus Midazolam 10 mg/2 mL Solution for Injection (Hypnovel®): A Single-Dose, Open-Label, Randomized, Two-Sequence, Two-Treatment, Two-Period Crossover Study in Healthy Subjects Under Fasting Conditions.
Protocol code: LESVIBUCCO/23/BQ-3
Sponsor: Laboratorios Lesvi S.L. (Pharmaceutical company). Phase: Human Pharmacology (Phase I)- Bioequivalence Study. Countries: Portugal (ended).
Therapeutic area(s): Not possible to specify
Gender: Female, Male. Age: 18-64 years, 65+ years. Enrolment: 24.
Status: Ended. Start date (EU): 2023-08-16. End date (EU): 2023-09-22. Decision date: 2023-06-22. Results received: Yes. Last updated: 2023-06-22.

Condition(s): No medical condition.
Product: BUCCOLAM 7.5 mg oromucosal solution, Hypnovel

Primary endpoint: Cmax and AUC0-t of midazolam and 1-OH-midazolam will be the primary pharmacokinetic parameters.
Endpoint(s): tmax, t1/2,AUC0-∞, %AUCextrap and λz of midazolam and 1-OH-midazolam will be the secondary pharmacokinetic parameters., Occurrence of treatment-emergent adverse events (TEAEs), including clinically relevant abnormalities from clinical laboratory tests and vital signs., Correlation of Cmax and AUC0–t of midazolam and 1-OH-midazolam as dependent variables with age and BMI as independent variables.

Source: https://euclinicaltrials.eu/ctis-public/view/2023-504903-10-00